EU clinical trial 2022-500185-94-01: Randomized, double-blind and multicentric study to assess the efficiency, security and tolerability of the faecal microbiota transfer in capsule form vs. placebo for the treatment of patients with non-alcoholic steatohepatitis (EMOTION)
Protocol code: NASH-001
Sponsor: Mikrobiomik Healthcare Company S.L. (Pharmaceutical company). Phase: Therapeutic exploratory (Phase II). Countries: Spain (authorised, recruitment pending).
Therapeutic area(s): Diseases [C] - Nutritional and Metabolic Diseases [C18]
Gender: Female, Male. Age: 18-64 years, 65+ years. Enrolment: 1.
Status: Authorised, recruitment pending. Decision date: 2025-02-17. Results received: No. Last updated: 2025-02-17.

Condition(s): non-alcoholic steatohepatitis
Product: microcrystalline cellulose Ph Eur, in hypromellose capsules, Lyophilized capsules of fecal microbiota

Primary endpoint: -Patient ratio with a NASH resolution without fibrosis worsening. -Patient ratio without fibrosis nor activity worsening. -Patient ratio with a MRI-PDFF betterment and without a fibrosis or activity worsening., Occurrence of adverse events (AE), severe AE (SAE), AE that result in the interruption of the study’s treatment, AE of special interest, and changes in the vital signs and the laboratory results during 72 weeks of treatment
Endpoint(s): Patient ratio with betterment regarding the lobular inflammation and/or ballooning without fibrosis worsening, Changes in fibrosis biomarkers, MRI-PDFF, Changes in anthropometric measurements, Changes in lipid profile, Changes in inflammation biomarkers, Changes in insulin resistance, Changes in vital signs, Changes in emerging CVR factors, Changes in the carotid ultrasound, Changes in the SF-36 questionnaire, Changes in the CLDQ-NAFLD questionnaire

Source: https://euclinicaltrials.eu/ctis-public/view/2022-500185-94-01